EU clinical trial 2024-514823-41-00: Clonal evolution in progressive CLL patients harboring subclonal TP53 aberrations treated with ibrutinib first-line
Sponsor: Ospedale San Raffaele S.r.l. (Hospital/Clinic/Other health care facility). Phase: Therapeutic exploratory (Phase II). Countries: Italy (ongoing, recruitment ended).
Therapeutic area(s): Diseases [C] - Neoplasms [C04]
Gender: Female, Male. Age: 18-64 years, 65+ years. Enrolment: 120.
Status: Ongoing, recruitment ended. Start date (EU): 2019-04-29. Decision date: 2024-08-05. Results received: No. Last updated: 2024-08-05.

Condition(s): Chronic Lymphocytic Leukemia (CLL)
Product: IBRUTINIB

Primary endpoint: TP53 mutated subclone size at WEEK 2,4,12,24,48,72,96 and yearly thereafter compared to baseline [i.e. (TP53 mutated alleles at WEEK 2,4,12,24,48,72,96 and yearly thereafter)/(TP53 mutated alleles at baseline)]

Source: https://euclinicaltrials.eu/ctis-public/view/2024-514823-41-00